EU clinical trial 2023-504466-28-00: A Phase I/II, open-ended, adaptative, open label dose escalation and expansion clinical trial to evaluate the efficacy and safety of unilateral intracochlear injection of SENS-501 using an injection system in children with severe to profound hearing loss due to Otoferlin gene mutations
Protocol code: SENS-501-101
Sponsor: Sensorion (Pharmaceutical company). Phase: Phase I and Phase II (Integrated)- First administration to humans. Countries: Italy (ended), France (ongoing, recruitment ended), Germany (ended).
Therapeutic area(s): Diseases [C] - Otorhinolaryngologic Diseases [C09]
Gender: Female, Male. Age: 0-17 years. Enrolment: 6.
Start date (EU): 2024-09-04. Decision date: 2024-01-17. Results received: No. Last updated: 2026-07-23.
Decision dates by country: FR: 2024-05-23, IT: 2024-01-18, DE: 2024-06-26

Condition(s): Bilateral severe to profound hearing loss due to Otoferlin deficiency.
Product: PREDNISOLONE, Adeno‐associated viral vector serotype 8 containing the 5' human otoferlin coding sequence, Adeno‐associated viral vector serotype 8 containing the 3' human otoferlin coding sequence, METHYLPREDNISOLONE

Primary endpoint: Part 1: Number of study-related adverse events and serious adverse events (through trial completion), Part 2: Number of patients who demonstrate an improvement of hearing threshold measured by ABR (through trial completion)
Endpoint(s): Part 1: Number of patients who demonstrate an improvement of hearing threshold measured by ABR (through trial completion), Part 2 : Number of study-related adverse events and serious adverse events (through trial completion), Part 1 and 2: Number of patients who demonstrate an improvement of hearing threshold measured by PTA (through trial completion), Part 1 and 2: Clinical performance and usability of SPHYNX Pump and Catheter (SPHYNX pump injection log, user feedback questionnaire, usability questionnaire - through trial completion)

Source: https://euclinicaltrials.eu/ctis-public/view/2023-504466-28-00